EU clinical trial 2024-513993-23-00: A PHASE 1/2 STUDY OF ALX148 IN COMBINATION WITH AZACITIDINE IN PATIENTS WITH HIGHER RISK MYELODYSPLASTIC SYNDROME (MDS) (ASPEN-02)
Protocol code: AT148002
Sponsor: Alx Oncology Holdings Inc. (Pharmaceutical company). Phase: Phase I and Phase II (Integrated)- Other. Countries: Spain (ended).
Therapeutic area(s): Diseases [C] - Neoplasms [C04]
Gender: Female, Male. Age: 18-64 years, 65+ years. Enrolment: 3.
Status: Ended. Start date (EU): 2022-09-21. End date (EU): 2025-06-10. End date: 2025-06-11. Decision date: 2024-06-18. Results received: Yes. Last updated: 2025-04-16.

Condition(s): Patients with higher risk myelodysplastic syndrome (MDS) who have not yet been treated for their disease
Product: AZACITIDINE

Primary endpoint: Phase 1, Dose escalation: First Cycle DLTs using CTCAE v5.0, Phase 1, Dose expansion: Adverse Events as characterized by type, frequency, severity (as graded by National Cancer Institute Common Terminology Criteria for Adverse Events (NCI CTCAE v. 5.0), timing, seriousness, and relationship to study therapy, Phase 2 part of the study is complete response rate (CRR), assessed by investigator using modifed IWG 2006 response criteria for MDS, defined as a best response of CR, with the final analysis to be performed after the last patient has completed 6 cycles of treatment or is considered evaluable for response.
Endpoint(s): Incidence of marrow CR, objective response rate (ORR), hematologic improvement (HI) in erythrocytes (E), platelets (P), and neutrophils (N), red blood cell (RBC) and platelet (PLT) transfusion independence, frequency and level of measurable residual disease (MRD), Duration of response (DOR), event-free survival (EFS), progression-free survival (PFS), overall survival (OS), time to progression (TTP)., Percentage of patients able to proceed to allogeneic hematopoietic stem cell transplant (allo-HSCT), Changes in global health status/quality of life (GHS/QoL) status based on patient reported outcome (PRO) assessment (Phase 2 only), Phase 1 dose escalation and Phase 2: Adverse Events as characterized by type, frequency, severity (as graded by National Cancer Institute Common Terminology Criteria for Adverse Events (NCI CTCAE v. 5.0), timing, seriousness, and relationship to study therapy;, Laboratory abnormalities as characterized by type, frequency, severity (as graded by NCI CTCAE v. 5.0) and timing, Pharmacokinetic parameters of ALX148 such as Cmax, Tmax, AUC, CL, and t1/2 as data permit, Immunogenicity; Human serum ADA (anti-ALX148 antibody) samples will be analyzed for the presence or absence of anti-ALX148 antibodies

Source: https://euclinicaltrials.eu/ctis-public/view/2024-513993-23-00